EU clinical trial 2025-520763-41-00: A Study to Learn About the Study Medicine Called PF-07258669 in Older Adults Including Those at Risk of Malnutrition
Protocol code: C4541011
Sponsor: Pfizer Inc. (Pharmaceutical company). Phase: Human Pharmacology (Phase I)- Other. Countries: Spain (ended).
Therapeutic area(s): Not possible to specify
Gender: Female, Male. Age: 65+ years. Enrolment: 4.
Status: Ended. End date (EU): 2025-12-15. End date: 2026-01-21. Decision date: 2025-11-19. Results received: No. Last updated: 2025-11-19.

Condition(s): Older adults at risk of malnutrition

Source: https://euclinicaltrials.eu/ctis-public/view/2025-520763-41-00